EU clinical trial 2024-510912-66-00: Local Levobupivacaine for pain relief after Endoscopic Submucosal Dissection for esophageal lesions: a Randomized Controlled Trial
Protocol code: ABR 85582.100.23
Sponsor: Sint Antonius Ziekenhuis Stichting (Hospital/Clinic/Other health care facility). Phase: Therapeutic use (Phase IV). Countries: Netherlands (ongoing, recruiting).
Therapeutic area(s): Diseases [C] - Digestive System Diseases [C06]; Diseases [C] - Neoplasms [C04]; Analytical, Diagnostic and Therapeutic Techniques and Equipment [E] - Anesthesia and Analgesia [E03]
Gender: Female, Male. Age: 18-64 years, 65+ years. Enrolment: 88.
Status: Ongoing, recruiting. Start date (EU): 2024-10-22. Decision date: 2024-08-23. Results received: No. Last updated: 2026-01-16.

Condition(s): Visible esophageal lesions ((pre)cancerous)
Product: Paracetamol Fresenius Kabi 10 mg/ml oplossing voor infusie, Diclofenac Na CF 25 mg/ml, oplossing voor injectie, Levobupivacaïne Fresenius Kabi 2,5 mg/ml, oplossing voor injectie/infusie

Primary endpoint: The proportion of patients with major pain within 90 minutes after the procedure comparing the LB and non-LB group. Major pain is defined as a score of four or higher based on a 0-10 NRS. The peak pain score (maximum reported pain score) at one of the three pre-defined time points of 30, 60 and 90 minutes after the procedure will be used for this.
Endpoint(s): - Pain scores based on a 0-10 NRS within 90 minutes after the procedure, 6 hours after the procedure and thereafter daily up to day 14., - Cumulative pain throughout 14 days based on the area under the curve of a pain versus time plot., - Duration of pain, defined as the number of days until pain scores were reported to be 0 on all following days., - Daily and overall use of analgesics up to day 14 post-procedurally registered in a patient diary (electronic or on paper)., - Incidence of adverse events related to LB administration (including allergic reactions to LB)., - Incidence of serious adverse events related to LB administration (including allergic reactions to LB)., - Length of hospital stay in days.

Source: https://euclinicaltrials.eu/ctis-public/view/2024-510912-66-00